EU clinical trial 2025-521672-60-00: A Phase 1/2 Dose Escalation Study of CRN09682 With an Expansion Phase in Participants with Progressive Metastatic Somatostatin Receptor Type 2 (SST2)-Expressing Neuroendocrine Neoplasms (NENs) and Other SST2-Expressing Solid Tumors
Protocol code: CRN09682-191
Sponsor: Crinetics Pharmaceuticals Inc. (Pharmaceutical company). Phase: Phase I and Phase II (Integrated)- First administration to humans. Countries: Spain (ongoing, recruiting), France (authorised, recruitment pending), Germany (authorised, recruitment pending), Italy (authorised, recruitment pending).
Therapeutic area(s): Diseases [C] - Neoplasms [C04]
Gender: Female, Male. Age: 18-64 years, 65+ years. Enrolment: 62.
Start date (EU): 2025-12-19. Decision date: 2025-11-21. Results received: No. Last updated: 2026-03-31.
Decision dates by country: FR: 2026-03-25, DE: 2026-03-19, IT: 2026-03-23, ES: 2025-11-21

Condition(s): Metastatic or locally advanced SST2-positive neuroendocrine neoplasms in adults

Primary endpoint: Dose Escalation Phase: Incidence and severity of DLTs., Dose Escalation Phase: Incidence and severity of AEs and SAEs at each dose level., Dose Escalation Phase: Incidence of AEs leading to discontinuation from study drug., Dose Expansion Phase: Nature, incidence, and severity of AEs and SAEs at the Expansion Dose., Dose Expansion Phase: Interruptions at the Expansion Dose.
Endpoint(s): Dose Escalation Phase: Plasma PK parameters of CRN09682, including Cmax, tmax, AUC0-last, AUC0-inf, and t½., Dose Escalation Phase: Plasma PK parameters of MMAE, including Cmax, tmax, and AUC0-last., Dose Escalation Phase: ORR=PR+CR by RECIST version 1.1 criteria., Dose Escalation Phase: DOR, defined as time from achieving at least a RECIST PR to disease progression., Dose Escalation Phase: DCR=PR+CR+SD by RECIST version 1.1 criteria., Dose Escalation Phase: Safety, tolerability, PK, and response by dose level., Dose Expansion Phase: ORR=PR+CR by RECIST version 1.1 criteria., Dose Expansion Phase: DOR, defined as time from achieving at least a RECIST version 1.1 PR to disease progression., Dose Expansion Phase: DCR=PR+CR+SD by RECIST version 1.1 criteria., Dose Expansion Phase: Radiographic PFS (defined as time from enrollment to disease progression)., Dose Expansion Phase: Changes in somatostatin receptor imaging., Dose Expansion Phase: Plasma concentrations of CRN09682 and MMAE at predose and EOI.

Source: https://euclinicaltrials.eu/ctis-public/view/2025-521672-60-00